EU clinical trial 2024-511822-30-00: Fecal microbiota transplantation in Crohn’s disease as relay after anti-TNF withdrawal (MIRACLE)
Protocol code: APHP 190183
Sponsor: Assistance Publique Hopitaux De Paris (Hospital/Clinic/Other health care facility). Phase: Phase III and phase IV (Integrated). Countries: France (ongoing, recruiting).
Therapeutic area(s): Diseases [C] - Digestive System Diseases [C06]
Gender: Female, Male. Age: 18-64 years, 65+ years. Enrolment: 350.
Status: Ongoing, recruiting. Start date (EU): 2021-09-22. Decision date: 2024-10-29. Results received: No. Last updated: 2025-07-15.

Condition(s): Crohn’s disease
Product: Enema transplant of fecal microbiota, Placebo double encapsulated oral transplant of fecal microbiota, Placebo coloscopic transplant of Fecal microbiota, Double encapsulated oral transplant of fecal microbiota

Primary endpoint: Clinical remission (defined by a CDAI <150) at week 52 (V8) without any flare between week 0 (colonoscopy (V2)) and week 52 (V8). Flare is defined by a CDAI (Addendum 2) above 250 or between 150 points and 250 points with a 70-point increase from baseline (v0 : inclusion) over 2 consecutive weeks and the need to start any new treatment for CD.
Endpoint(s): Relapse free survival rate from week 0 (V2) to week 52 (V8), Proportion of endoscopic remission (SES-CD ≤2) at week 52 (V8) and change (in %) in endoscopic score (SES-CD) between week 0 (V2) and 52 (V8), Clinical remission defined by a CDAI < 150 at week 52; endoscopic remission defined by a SES-CD ≤ 2., Measures of inflammation: blood cell count, CRP level, fecal calprotectin at week 6 (V3), 12 (V4), 24 (V5), 36 (V6), 48 (V7) and 52 (V8), Microbiota composition and diversity using 16s sequencing technology at week 6 (V3), 12 (V4), 24 (V5), 36 (V6), 48 (V7) and 52 (V8)

Source: https://euclinicaltrials.eu/ctis-public/view/2024-511822-30-00